EU clinical trial 2025-521088-10-00: A Single-arm, Phase 2, Open-label, Multicenter Study to Evaluate NX-5948 in Adults with Relapsed/Refractory (R/R) Chronic Lymphocytic Leukemia (CLL) or Small Lymphocytic Lymphoma (SLL) Previously Exposed to a Bruton’s Tyrosine Kinase Inhibitor (BTKi) and a B-cell Lymphoma-2 Inhibitor (BCL-2i)
Protocol code: NX-5948-201
Sponsor: Nurix Therapeutics Inc. (Pharmaceutical company). Phase: Therapeutic exploratory (Phase II). Countries: France (ongoing, recruiting), Italy (authorised, recruiting), Hungary (ended), Poland (ongoing, recruiting).
Therapeutic area(s): Diseases [C] - Neoplasms [C04]
Gender: Female, Male. Age: 18-64 years, 65+ years. Enrolment: 41.
Start date (EU): 2025-10-23. Decision date: 2025-10-02. Results received: No. Last updated: 2026-04-21.
Decision dates by country: HU: 2025-10-03, PL: 2025-10-06, IT: 2025-10-03, FR: 2025-10-02

Condition(s): Relapsed/Refractory (R/R) Chronic Lymphocytic Leukemia (CLL) or Small Lymphocytic Lymphoma (SLL)
Product: NX-5948

Primary endpoint: ORR (without PR-L) as assessed by IRC
Endpoint(s): ORR with PR-L as assessed by IRC, DOR as assessed by IRC and by investigator, PFS as assessed by IRC and by investigator, Complete response rate as assessed by IRC and by investigator, TTR as assessed by IRC and by investigator, OS, Including, but not limited to, incidence and severity of TEAEs, SAEs and TEAEs leading to study drug discontinuation, Changes from baseline in laboratory parameters and vital signs, Summary measures of PK trough concentrations, ORR (with and without PR-L) as assessed by investigator, PROs measured by EORTC QLQ-C30 and EQ-5D-5L questionnaires

Source: https://euclinicaltrials.eu/ctis-public/view/2025-521088-10-00